EU clinical trial 2023-503389-22-00: A Study of SGN-B7H4V in Advanced Solid Tumors
Protocol code: SGNB7H4V-001
Sponsor: Seagen Inc. (Pharmaceutical company). Phase: Human Pharmacology (Phase I)- First administration to humans. Countries: France (ended), Spain (ended), Italy (ended), Germany (ended).
Therapeutic area(s): Diseases [C] - Neoplasms [C04]
Gender: Female, Male. Age: 18-64 years, 65+ years. Enrolment: 147.
Status: Ended. Start date (EU): 2022-08-31. End date (EU): 2025-01-13. End date: 2025-05-14. Decision date: 2024-04-05. Results received: No. Last updated: 2024-08-23.
Decision dates by country: IT: 2024-04-09, FR: 2024-04-05, ES: 2024-04-08, DE: 2024-04-08

Condition(s): Fallopian tube cancer, Gallbladder carcinoma, Triple-negative breast cancer, Primary peritoneal cancer, HER2-negative, HR-positive breast cancer, Non-small cell lung cancer (squamous cell carcinoma [SqCC]), High-grade serous epithelial ovarian cancer, Adenoid cystic carcinoma (ACC), Endometrial carcinoma, Cholangiocarcinoma

Source: https://euclinicaltrials.eu/ctis-public/view/2023-503389-22-00